EU clinical trial 2024-515516-50-00: Matrix-Directed Therapy In Older Adolescents And Adults With Osteogenesis Imperfecta – The “MOI-A” Study
Protocol code: MOI-A
Sponsor: Istituto Ortopedico Rizzoli (Hospital/Clinic/Other health care facility). Phase: Therapeutic exploratory (Phase II). Countries: Italy (ongoing, recruiting).
Therapeutic area(s): Diseases [C] - Musculoskeletal Diseases [C05]
Gender: Female, Male. Age: 0-17 years, 18-64 years, 65+ years. Enrolment: 15.
Status: Ongoing, recruiting. Start date (EU): 2025-09-18. Decision date: 2025-03-13. Results received: No. Last updated: 2026-07-13.

Condition(s): Osteogenesis Imperfecta
Product: LOSARTAN

Primary endpoint: Percentage change in CTX from baseline to week 24
Endpoint(s): Percentage change in CTX from baseline to week 8, Percentage change in TGFβ & P1NP from baseline to week 8 and w24, Change in DXA LSaBMD from baseline to w24, Change in radial and tibial total vBMD by HRpQCT from baseline to w24, Change in Timed Up and Go test from baseline to w24, Change in QoL using OI-QOL & EQ-5D-5L-VAS from baseline to w24

Source: https://euclinicaltrials.eu/ctis-public/view/2024-515516-50-00